EU clinical trial 2023-504195-14-00: A Randomized, Open-label, Phase 3 Study of Sacituzumab Govitecan Versus Treatment of Physician’s Choice in Patients With Previously Untreated, Locally Advanced, Inoperable or Metastatic Triple-Negative Breast Cancer Whose Tumors Do Not Express PD-L1 or in Patients Previously Treated With Anti-PD-(L)1 Agents in the Early Setting Whose Tumors Do Express PD-L1
Protocol code: GS-US-592-6238
Sponsor: Gilead Sciences Inc. (Pharmaceutical company). Phase: Therapeutic confirmatory (Phase III). Countries: Germany (ongoing, recruitment ended), Spain (ongoing, recruitment ended), Austria (ongoing, recruitment ended), Italy (ongoing, recruitment ended), France (ongoing, recruitment ended), Poland (ongoing, recruitment ended), Czechia (ongoing, recruitment ended), Slovakia (ended), Belgium (ongoing, recruitment ended), Netherlands (ongoing, recruitment ended), Romania (ongoing, recruitment ended), Hungary (ongoing, recruitment ended).
Therapeutic area(s): Diseases [C] - Neoplasms [C04]
Gender: Female, Male. Age: 18-64 years, 65+ years. Enrolment: 167.
Start date (EU): 2022-08-31. Decision date: 2024-11-05. Results received: No. Last updated: 2026-05-27.
Decision dates by country: NL: 2024-11-05, AT: 2024-12-27, ES: 2024-11-15, CZ: 2024-11-11, PL: 2024-11-24, DE: 2024-11-05, IT: 2024-11-19, SK: 2024-11-05, BE: 2024-11-06, RO: 2024-11-07, HU: 2024-11-08, FR: 2024-11-29

Condition(s): PD-L1-negative metastatic triple-negative breast cancer or PD-L1-positive metastatic triple-negative breast cancer previously treated with an anti-PD-(L)1 agent in the curative setting
Product: Paclitaxel 6 mg/ml concentrate for solution for infusion, Trodelvy 200 mg powder for concentrate for solution for infusion, Abraxane 5 mg/ml powder for dispersion for infusion., Gemcitabine 38 mg/mL concentrate for solution for infusion, Carboplatin 10 mg/ml concentrate for solution for infusion

Primary endpoint: PFS is defined as the time from the date of randomization until the date of objective progressive disease (PD), as assessed by BICR per Response Evaluation Criteria in Solid Tumors (RECIST) Version 1.1, or death (whichever comes first).
Endpoint(s): OS is defined as the time from the date of randomization until death due to any cause., ORR is defined as the proportion of patients who achieve a CR or PR that is confirmed at least 4 weeks after initial documentation of response as assessed by BICR per RECIST Version 1.1., DOR is defined as the time from the first documentation of CR or PR to the earlier of the first documentation of definitive PD or death from any cause (whichever comes first) as assessed by BICR per RECIST Version 1.1., TTR is defined as the time from the date of randomization until the first documentation of CR or PR as assessed by BICR per RECIST Version 1.1., Incidence of treatment-emergent AEs (TEAEs) and clinical laboratory abnormalities., Mean change from baseline in the physical functioning domain of the EORTC QLQ-C30 at Week 25, TTD of fatigue domain of the EORTC QLQ-C30 is defined as the time between the date of randomization and the date of assessment at which a patient experienced a deterioration (ie, ≥ 10 points worsening from baseline in the fatigue domain) or death

Source: https://euclinicaltrials.eu/ctis-public/view/2023-504195-14-00